EU clinical trial 2023-507716-13-00: A Phase 2b Clinical Study to Evaluate the Safety and Efficacy of Topical Administration of Bacteriophage Therapy TP-102 in Patients with Diabetic Foot Infection
Protocol code: TP-102_102
Sponsor: Technophage Investigacao E Desenvolvimento Em Biotecnologia S.A. (Pharmaceutical company). Phase: Therapeutic exploratory (Phase II). Countries: Poland (ended).
Therapeutic area(s): Diseases [C] - Skin and Connective Tissue Diseases [C17]; Diseases [C] - Bacterial Infections and Mycoses [C01]
Gender: Female, Male. Age: 18-64 years, 65+ years. Enrolment: 26.
Status: Ended. End date (EU): 2025-12-19. Decision date: 2024-01-22. Results received: No. Last updated: 2025-08-18.

Condition(s): Diabetic foot ulcers infected by Acinetobacter baumannii, Pseudomonas aeruginosa and /or Staphylococcus aureus
Product: Cloreto de Sódio 0,9 % Labesfal, 9 mg/ml, Solução injetável, TP-102

Primary endpoint: Number and percentage of Treatment Emergent Adverse Events (TEAEs) [Day 1 (Baseline) to EOT];, Statistically significant change in the percentage of patients in the respective IWGDF/IDSA classes for TP-102 versus Placebo, in addition to SoC [Day 1 (Baseline) to EOT];, Percentage of patients that achieve at least 50% reduction in wound surface area by week 4 for TP-102 versus Placebo, in addition to SoC [Day 1 (Baseline) to EOT].
Endpoint(s): Change in mean CRP/ESR/PCT/WBC count value for TP-102 versus Placebo, in addition to SoC [Day 1 (Baseline) to EOT];, Percentage of patients with a value over clinical diagnostic cut-off for DFI for CRP/ESR/PCT/WBC count for TP-102 versus Placebo, in addition to SoC [Day 1 (Baseline) to EOT];, Percentage eradication of TP-102 susceptible strains for TP-102 versus Placebo, in addition to SoC, at EOT;, Percentage of patients with target strain not-susceptible to TP-102 for TP-102 versus Placebo, in addition to SoC, at EOT;, Changes in wound size, depth, granulation and partial closure (25%, 50%, 75%)from baseline, for TP-102 versus Placebo, in addition to SoC [Day 3, 8, 15, EOT and EOS]., Percentage of patients that achieve wound healing (complete wound closure) by EOS for TP-102 versus Placebo, in addition to SoC [Day 1 (Baseline) to FUP2]., Total Area Under the Curve (AUC) of the mean DFUWI score for TP-102 versus Placebo, in addition to SoC [Day 1 (Baseline) to EOT].

Source: https://euclinicaltrials.eu/ctis-public/view/2023-507716-13-00